EU clinical trial 2024-512030-15-00: Efficacy of Diltiazem to improve coronary microvascular dysfunction: a randomized clinical trial
Sponsor: Stichting Radboud universitair medisch centrum (Hospital/Clinic/Other health care facility). Phase: Phase III and phase IV (Integrated). Countries: Netherlands (ended).
Therapeutic area(s): Diseases [C] - Cardiovascular Diseases [C14]
Gender: Female, Male. Age: 18-64 years, 65+ years. Enrolment: 126.
Status: Ended. End date (EU): 2026-04-21. Decision date: 2024-04-04. Results received: No. Last updated: 2024-04-04.

Condition(s): Angina
Product: CELLULOSE, MICROCRYSTALLINE, Diltiazem HCl Auro retard 120 mg, tabletten met gereguleerde afgifte

Primary endpoint: The proportion of patients having a successful treatment with diltiazem, defined as normalization of at least one abnormal parameter and none of the normal parameters becoming abnormal. A normal IMR is specified as IMR < 25, a normal CFR being a CFR > 2 and a normal acetylcholine test is specified as one without spasm, without ischemic ECG abnormalities and without (recognizable) angina at the same acetylcholine dose used at baseline.

Source: https://euclinicaltrials.eu/ctis-public/view/2024-512030-15-00